EU clinical trial 2023-506694-35-00: PPOS and CFA for elective Freeze-All ovarian stimulation cycles: a prospective cross-over study
Protocol code: P-CCROSS
Sponsor: Universitair Ziekenhuis Gent (Hospital/Clinic/Other health care facility). Phase: Therapeutic use (Phase IV). Countries: Belgium (ongoing, recruiting).
Therapeutic area(s): Phenomena and Processes [G] - Reproductive and Urinary Physiological Phenomena [G08]
Gender: Female. Age: 18-64 years. Enrolment: 60.
Status: Ongoing, recruiting. Start date (EU): 2025-01-24. Decision date: 2023-10-27. Results received: No. Last updated: 2025-04-09.

Condition(s): Subfertility
Product: Orgalutran 0.25 mg/0.5 mL solution for injection, Gonapeptyl Daily 0,1 mg/1 ml, oplossing voor injectie, Elonva 150 micrograms solution for injection, Puregon 300 IU/0.36 mL solution for injection, Gonapeptyl Daily 0,1 mg/ml, Injektionslösung, Gonapeptyl Daily 0,1 mg/1 ml, solution injectable, Cerazette 75 microgram film-coated tablets, Puregon 900 IU/1.08 mL solution for injection, Orgalutran 0.25 mg/0.5 mL solution for injection, Puregon 600 IU/0.72 mL solution for injection

Primary endpoint: Treatment-related quality of life and patient satisfaction retrieved from the second questionnaire (Q2), which is completed at the end of each stimulation cycle; after the agonist trigger and before the oocyte retrieval.
Endpoint(s): Patient feedback derived from the third questionnaire (Q3), which is completed within 3 weeks after completing the second stimulation cycle.

Source: https://euclinicaltrials.eu/ctis-public/view/2023-506694-35-00